EU clinical trial 2024-520222-11-00: A Long-Term Follow-up Study for Subjects Previously Treated with A Century Therapeutics Cellular Therapy Product
Protocol code: CNTY-LTFU-01
Sponsor: Century Therapeutics Inc. (Pharmaceutical company). Phase: Human Pharmacology (Phase I)- Other. Countries: France (ended), Italy (ended), Germany (ongoing, recruiting).
Therapeutic area(s): Diseases [C] - Immune System Diseases [C20]; Diseases [C] - Skin and Connective Tissue Diseases [C17]; Diseases [C] - Nervous System Diseases [C10]; Diseases [C] - Neoplasms [C04]
Gender: Female, Male. Age: 18-64 years, 65+ years. Enrolment: 15.
Start date (EU): 2026-03-03. Decision date: 2025-07-22. Results received: No. Last updated: 2025-12-19.
Decision dates by country: FR: 2025-07-24, DE: 2025-07-22, IT: 2025-07-22

Condition(s): Hematological or solid tumor malignancies or autoimmune diseases

Source: https://euclinicaltrials.eu/ctis-public/view/2024-520222-11-00